EU clinical trial 2025-522254-39-00: Single dose, open-label, laboratory blinded, randomized, 2-treatment, 2-period, 2-sequence, crossover, pivotal study to assess the comparative bioavailability of Test Product Dapagliflozin/metformin hydrochloride 5 mg/1000 mg film-coated tablets to Reference Product Xigduo 5 mg/1000 mg film-coated tablets in healthy adult male and female subjects under fed conditions.
Protocol code: 1019/25
Sponsor: Laboratorios Cinfa S.A. (Pharmaceutical company). Phase: Human Pharmacology (Phase I)- Other. Countries: Czechia (ended).
Therapeutic area(s): Not possible to specify
Gender: Female, Male. Age: 18-64 years. Enrolment: 32.
Status: Ended. Start date (EU): 2025-09-29. End date (EU): 2025-10-22. Decision date: 2025-09-10. Results received: No. Last updated: 2025-09-22.
Decision dates by country: CZ: 2025-09-22

Condition(s): Bioavailability study in healthy volunteers under fed conditions.

Source: https://euclinicaltrials.eu/ctis-public/view/2025-522254-39-00